EU clinical trial 2024-515948-23-00: GCO-003 TARLANEC A randomized phase III trial study comparing tarlatamab with standard of care chemotherapy in patients with pre-treated advanced, refractory pulmonary or gastroenteropancreatic poorly differentiated neuroendocrine carcinomas
Protocol code: GCO-003 TARLANEC
Sponsor: Intergroupe Francophone De Cancerologie Thoracique (Patient organisation/association). Phase: Therapeutic confirmatory (Phase III). Countries: France (ongoing, recruiting).
Therapeutic area(s): Diseases [C] - Neoplasms [C04]
Gender: Female, Male. Age: 18-64 years, 65+ years. Enrolment: 129.
Status: Ongoing, recruiting. Start date (EU): 2026-02-06. Decision date: 2025-09-02. Results received: No. Last updated: 2025-09-02.

Condition(s): Advanced pulmonary or gastroenteropancreatic poorly differentiated neuroendocrine carcinomas (NECs)
Product: Tarlatamab, OXALIPLATINE VIATRIS 5 mg/ml, poudre pour solution pour perfusion, Dacarbazine "Lipomed", Tecentriq 1 200 mg concentrate for solution for infusion, Docetaxel Accord 80 mg/4 ml concentrate for solution for infusion, Temozolomide 100 mg hard capsules, OPDIVO 10 mg/mL concentrate for solution for infusion., KEYTRUDA 25 mg/mL concentrate for solution for infusion, Topotecan Accord Healthcare 4mg Powder for Concentrate for Solution for Infusion, IRINOTECAN VIATRIS 20 mg/ml, solution à diluer pour perfusion, FLUOROURACILE ACCORD 50 mg/ml, solution à diluer pour perfusion

Primary endpoint: Overall survival (OS) in patients who received at least one dose of treatment.
Endpoint(s): Incidence, nature, and severity of treatment-related adverse events/treatment-emergent adverse events, graded according to the NCI CTCAE v5.0 except CRS and ICANS events graded using ASTCT 2019, Objective Response Rate (ORR), Duration of response (DoR), Disease Control Rate (DCR), Progression Free Survival (PFS), Overall Survival (OS), Quality of life of questionnaire EORTC QLQ-C30

Source: https://euclinicaltrials.eu/ctis-public/view/2024-515948-23-00